EU clinical trial 2024-516683-29-00: A multicenter open-label randomized controlled prospective phase II study evaluating the efficacy of Selective Internal Radiation Therapy (Yttrium-90 glass microspheres) combined with Capecitabine in the neoadjuvant setting of Operable intrahepatic CHOlangiocarcinoma
Protocol code: 2017-02-32-005
Sponsor: Centre De Lutte Contre Le Cancer Eugene Marquis (Hospital/Clinic/Other health care facility). Phase: Therapeutic exploratory (Phase II). Countries: France (authorised, recruiting).
Therapeutic area(s): Diseases [C] - Neoplasms [C04]
Gender: Female, Male. Age: 18-64 years, 65+ years. Enrolment: 62.
Status: Authorised, recruiting. Start date (EU): 2022-02-04. Decision date: 2024-08-23. Results received: No. Last updated: 2025-05-13.

Condition(s): Biliary tract cancer
Product: Capecitabine Accord 500 mg film-coated tablets

Primary endpoint: Frequency of subjects with adequate surgical margins, defined as the number of resections and margin >= 5mm, Frequency of subjects actually resected, Frequency of subjects with R0 and R1 resection, Frequency of subjects with an observed objective response, Mean percentage of tissue with necrosis in resected specimen, Disease-Free survival, Overall survival

Source: https://euclinicaltrials.eu/ctis-public/view/2024-516683-29-00